EU clinical trial 2024-512292-12-00: A double blind, double dummy, multicenter, randomized, placebo- and active-controlled clinical trial to evaluate effectiveness of Tricortin 1000 in patients affected by chronic low back pain
Protocol code: EQ06.17.01
Sponsor: Fidia Farmaceutici S.p.A. (Pharmaceutical company). Phase: Therapeutic use (Phase IV). Countries: Italy (ongoing, recruiting).
Therapeutic area(s): Diseases [C] - Musculoskeletal Diseases [C05]
Gender: Female, Male. Age: 18-64 years, 65+ years. Enrolment: 300.
Status: Ongoing, recruiting. Start date (EU): 2019-02-20. Decision date: 2024-12-10. Results received: No. Last updated: 2026-08-07.

Condition(s): Low Back Pain
Product: TRICORTIN 1000 “12 mg+1 mg/2 ml soluzione iniettabile per uso intramuscolare”, ITAMI 140 mg cerotto medicato, Placebo 1 - injectable solution, Placebo 2 - plaster, ACETAMOL adulti 500 mg compresse

Primary endpoint: Mean change from baseline to Day 15 in NRS-11
Endpoint(s): LBP related disability improvement measured through the Oswestry Low Back Pain Disability Index (ODI), version 2.1a, at baseline visit and then in the following visits: V3-Day 7 and V4-Day 15., Clinical improvement evaluated at baseline visit and then at V3-Day 7 and V4-Day 15 through the following parameters: Range of Motion testing, Joint reflex changes (ROT), Lasegue’s test (passive straight leg raise), Femoral stretch test (Wasserman test), Dandy’s sign, Valleix’s points pressure, PGA and CGI of the status of LBP evaluated at baseline visit and then in the following visits: V3-Day 7 and V4-Day 15, Daily rescue medication required for pain relief, Safety of daily intramuscular Tricortin 1000 injections and of twice daily diclofenac sodium medicated plaster applications evaluated by physical examination, vital signs and by tracking the number of patient withdrawals and their adverse events at each visit.

Source: https://euclinicaltrials.eu/ctis-public/view/2024-512292-12-00